EU clinical trial 2022-502277-41-00: A Study to Investigate the Effect of Hepatic Impairment on the Pharmacokinetics, Safety and Tolerability of Camizestrant in Post-menopausal Female Subjects
Protocol code: D8532C00002
Sponsor: AstraZeneca AB (Pharmaceutical company). Phase: Human Pharmacology (Phase I)- Other. Countries: Bulgaria (ended), Slovakia (ended).
Therapeutic area(s): Diseases [C] - Digestive System Diseases [C06]
Gender: Female. Age: 18-64 years, 65+ years. Enrolment: 14.
Status: Ended. Start date (EU): 2023-06-05. End date (EU): 2024-02-22. End date: 2024-02-23. Decision date: 2023-05-19. Results received: No. Last updated: 2024-03-25.
Decision dates by country: SK: 2023-05-19, BG: 2023-05-25

Condition(s): moderate or severe hepatic impairment

Source: https://euclinicaltrials.eu/ctis-public/view/2022-502277-41-00